EU clinical trial 2023-504224-26-00: A Study to Evaluate Safety and Pharmacokinetics of RO7198457 as a Single Agent and in Combination with Atezolizumab in Patients with Locally Advanced or Metastatic Tumors
Protocol code: GO39733
Sponsor: Genentech Inc. (Pharmaceutical company). Phase: Human Pharmacology (Phase I)- First administration to humans. Countries: Germany (ended), Belgium (ended).
Therapeutic area(s): Not possible to specify; Diseases [C] - Neoplasms [C04]
Gender: Female, Male. Age: 18-64 years, 65+ years. Enrolment: 41.
Status: Ended. Start date (EU): 2018-07-03. End date (EU): 2025-06-16. End date: 2025-07-01. Decision date: 2024-08-28. Results received: No. Last updated: 2025-03-26.
Decision dates by country: BE: 2024-08-28, DE: 2024-08-29

Condition(s): Advanced tumors

Source: https://euclinicaltrials.eu/ctis-public/view/2023-504224-26-00